EU clinical trial 2023-507358-34-00: Multicenter, double-blind, randomized, placebo-controlled, dose-response trial with the full-spectrum Cannabis Extract VER-01 in patients with chronic non-specific low back pain
Protocol code: VER-CLBP-004
Sponsor: Vertanical GmbH (Pharmaceutical company). Phase: Therapeutic exploratory (Phase II). Countries: Germany (ended), Czechia (ended), Spain (ended), Poland (ended).
Therapeutic area(s): Diseases [C] - Musculoskeletal Diseases [C05]
Gender: Female, Male. Age: 18-64 years, 65+ years. Enrolment: 767.
Status: Ended. Start date (EU): 2024-02-13. End date (EU): 2025-07-31. End date: 2025-08-01. Decision date: 2024-01-12. Results received: No. Last updated: 2025-08-15.
Decision dates by country: PL: 2024-05-07, CZ: 2024-05-13, ES: 2024-09-05, DE: 2024-01-12

Condition(s): For the treatment of patients with chronic non-specific low back pain when drug treatment is indicated and previous optimised treatments with non-opioid analgesics have not led to sufficient pain relief or were unsuitable due to contraindications or intolerance.
Product: PARACETAMOL, IBUPROFEN, IBUPROFEN, PANTOPRAZOLE, VER-01 Placebo, IBUPROFEN, PARACETAMOL, VER-01, PARACETAMOL, IBUPROFEN, IBUPROFEN, PARACETAMOL, IBUPROFEN

Primary endpoint: The primary endpoint is the change in mean pain intensity measured on a 11-point numerical rating scale (NRS) from Baseline (Week -1) to the end of the Treatment Phase (Week 7 of the Treatment Phase).
Endpoint(s): Number and percentage of 30% and 50% pain responders at the end of the Treatment Phase (Week 7 of the Treatment Phase) compared to Baseline (Week -1), Change of mean chronic low back pain interference with sleep evaluated on an 11-point NRS at the end of the Treatment Phase (Week 7 of the Treatment Phase) compared to Baseline (Week -1), Number and percentage of patients with a 30% and 50% improvement of the mean pain interference with sleep score evaluated on an 11-point NRS at the end of the Treatment Phase (Week 7 of the Treatment Phase) compared to Baseline (Week -1), Number of days with intake of rescue medication, cumulative dose, and relative cumulative dose of rescue medication, Percentage of patients by category (‘Improved’, ‘Not improved’) of global assessment of symptoms evaluated on the patient global impression of change (PGIC) with a 7-point Likert scale at Visit 4, Occurrence of treatment-emergent adverse events (TEAEs)/treatment-emergent serious adverse events (TESAEs), Percentage of patients by categorybased on the satisfaction of the patient with tolerability at Visit 4 on a 5-point Likert scale, Occurrence of addictive behavior based on the Addiction Behaviors Checklist (ABC) at Visit 3, 4, and 5, Occurrence of symptoms of abrupt drug withdrawal based on the Study Medication Withdrawal Questionnaire Version 2 (SMWQ V2) during the Wash-out Phase

Source: https://euclinicaltrials.eu/ctis-public/view/2023-507358-34-00